EU clinical trial 2022-502784-37-00: A reactogenicity, safety and immunogenicity study of GSK's paediatric Herpes Zoster subunit candidate vaccine (PED-HZ/su) GSK143713A in immunocompromised paediatric renal transplant recipients
Protocol code: 200075
Sponsor: GlaxoSmithKline Biologicals (Pharmaceutical company). Phase: Therapeutic exploratory (Phase II). Countries: France (ongoing, recruitment ended), Spain (ongoing, recruitment ended), Italy (ongoing, recruitment ended), Belgium (ended), Greece (ended), Poland (ongoing, recruitment ended).
Therapeutic area(s): Diseases [C] - Immune System Diseases [C20]
Gender: Female, Male. Age: 0-17 years. Enrolment: 134.
Start date (EU): 2019-09-03. Decision date: 2023-03-03. Results received: No. Last updated: 2026-08-05.
Decision dates by country: GR: 2023-12-19, PL: 2024-01-26, FR: 2023-03-03, IT: 2023-03-13, BE: 2023-12-14, ES: 2023-03-03

Condition(s): Prevention of Herpes Zoster in immunocompromised subjects aged 1-17 years

Primary endpoint: Occurrence of solicited loc. AEs and solicited gen. AEs/symptoms in subj. aged 1-11 and 12-17 years. For vaccinated subj., occurrence, intensity and duration of each solicited local AE within 7D after each vac. For vaccinated subj., occurrence, intensity, duration and relationship to vaccination of each solicited general AE within 7D after each vaccination. For non-interventional control group, occurrence, intensity and duration of each solicited gen. symptoms within 7D of VD1 and VM1., Occurrence of unsolicited AEs/symptoms in subj aged 1-11 and 12-17 years. - For vaccinated subj, occurrence, intensity, duration and relationship to vaccination of unsolicited AEs during 30D after each vaccination, classified according to the Medical Dictionary for Regulatory Activities (MedDRA) classification. - For non-interventional control group, occurrence, intensity and duration of unsolicited symptoms during 30D after VD1 and VM1 classified according to MedDRA classification., Occurrence of SAEs, pIMDs and renal allograft rejection in subjects aged 1-11 and 12-17 years. - For vaccinated subjects, the occurrence and relationship to vaccination of all SAEs, pIMDs and biopsy-confirmed renal allograft rejection from Visit Day 1 (first vaccination) up to Visit Month 2 (one month post-dose 2). - For the non-interventional control group, the occurrence of all SAEs, pIMDs and biopsy-confirmed renal allograft rejection from Visit Day 1 up to Visit Month 2., Occurrence of seizures in subjects 1-11 and 12-17 years. - For vaccinated subjects, the occurrence, intensity, duration and relationship to vaccination of seizures during the 30 days after each vaccination, classified according to the MedDRA classification. - For the non-interventional control group, the occurrence, intensity, duration of seizures during the 30 days after Visit Day 1 and Visit Month 1, classified according to the MedDRA classification., Occurrence of generalised convulsive seizures (classified by Brighton classification) in subjects aged 1-11 and 12-17 years. - For vaccinated subjects, the occurrence of generalised convulsive seizures occurring within 7 days after each vaccination. - For the non-interventional control group, the occurrence of generalised convulsive seizures occurring within 7 days of Visit Day 1 and Visit Month 1., Anti-gE antibody concentrations (geometric mean concentration) at Month 2 (one month post-dose 2) in each age category (1-11 and 12-17 years).
Endpoint(s): Occurrence of SAEs, pIMDs and renal allograft rejection in subjects aged 1-11 and 12-17 years. - For vaccinated subj.,occurrence and relationship to vaccination of all SAEs, pIMDs and biopsy confirmed renal allograft rejection from VD1 up to VM13. - For non-interventional control group, occurrence of SAEs, pIMDs and biopsy confirmed renal allograft rejection from VD1 up to VM13., Occurrence of HZ in subj aged 1-11 and 12-17 years. - For vaccinated subj, occurrence of HZ from VD1 until VM13. - For non-interventional control group, occurrence of HZ from VD1 until VM13., Occurrence of solicited local AEs and gen. AEs/gen.symptoms in subj.aged 1-17 yrs: For vaccinated subj.(1-17 yrs),occurrence,intensity and duration of each solicited local AE within 7D after each vaccination. For vaccinated subj. (1-17 yrs),occurrence,intensity,duration and relationship to vaccination of each solicited gen. AE within 7D after each vacc. For non-interventional control group (1-17 yrs),occurrence,intensity and duration of each solicited gen. symptoms within 7D after VD1 and VM1., Occurrence of unsolicited AEs/unsolicited symptoms in subjects aged 1-17 years. - For vaccinated subjects, the occurrence, intensity, duration and relationship to vaccination of unsolicited AEs during 30 days after each vaccination, classified according to MedDRA classification. - For the non-interventional control group, the occurrence intensity and duration of unsolicited symptoms during 30 days after Visit Day 1 and Visit Month 1 classified according to MedDRA classification., Occurrence of SAEs, pIMDs and renal allograft rejection in subjects aged 1-17 years: For vaccinated subj, occurrence and relationship to vaccination of all SAEs, pIMDs and biopsy-confirmed renal allograft rejection from VD1 until VM2 & from VD1 to VM13 For non-interventional control group, occurrence of all SAEs, pIMDs and biopsy-confirmed renal allograft rejection from VD1 until VM2 & from VD1 until VM13., Occurrence of HZ in subjects 1-17 years. - For vaccinated subjects the occurrence of HZ from Visit Day 1 until Visit Month 13. - For the non-interventional control group, the occurrence of HZ from Visit Day 1 until Visit Month 13., Occurrence of seizures in subjects 1-17 years. - For vaccinated subjects, the occurrence, intensity, duration and relationship to vaccination of seizures during the 30 days after each vaccination, classified according to the MedDRA classification. - For the non-interventional control group, the occurrence, intensity and duration of unsolicited symptoms during the 30 days after Visit Day 1 and Visit Month 1 classified according to the MedDRA classification., Occurrence of generalised convulsive seizures (according to Brighton classification) in subjects aged 1-17 years. - For vaccinated subjects, the occurrence and relationship of generalised convulsive seizures occurring within 7 days after each vaccination. - For non-interventional control group, the occurrence of generalised convulsive seizures occurring within 7 days following Visit Day 1 and Visit Month 1., VRR for anti-gE humoral immunogenicity at M2 and M13 for subj in each age category (1-11 and 12-17 years) and in the combined age category (1-17 years). - Median fold increase for anti gE antibodies at M2 and M13 for subj in each age category (1-11 and 12-17 y) - Anti-gE antibody concentrations (GMCs) at D1 (pre-vacc) and M13 in each age category (1-11 and 12-17 y) - Anti-gE antibody concentrations (GMCs and median fold increase) at D1,M2 and M13 in pooled age category (1-17 y)

Source: https://euclinicaltrials.eu/ctis-public/view/2022-502784-37-00